EU clinical trial 2024-519656-85-00: Oral vs Intravenous Fluids – healthy volunteers
Protocol code: SVS.FAM.03
Sponsor: Esbjerg Og Grindsted Sygehus (Hospital/Clinic/Other health care facility). Phase: Human Pharmacology (Phase I)- Other. Countries: Denmark (ended).
Therapeutic area(s): Phenomena and Processes [G] - Circulatory and Respiratory Physiological Phenomena [G09]
Gender: Female, Male. Age: 18-64 years. Enrolment: 20.
Status: Ended. Start date (EU): 2025-03-18. End date (EU): 2025-05-01. Decision date: 2025-02-26. Results received: No. Last updated: 2025-02-26.

Condition(s): Hemodynamic parameters is to be investigated -- comparing intravenous fluid therapy to oral fluid therapy

Source: https://euclinicaltrials.eu/ctis-public/view/2024-519656-85-00